EU clinical trial 2024-512894-29-00: First in human study to evaluate the safety, tolerability and preliminary efficacy of the bispecific PSMAxCD3 antibody CC-1 in patients with castration resistant prostate carcinoma
Protocol code: PSMAxCD3
Sponsor: Universitaetsklinikum Tuebingen AöR (Hospital/Clinic/Other health care facility). Phase: Phase I and Phase II (Integrated)- First administration to humans. Countries: Germany (ongoing, recruiting).
Therapeutic area(s): Diseases [C] - Male Urogenital Diseases [C12]
Gender: Male. Age: 18-64 years, 65+ years. Enrolment: 44.
Status: Ongoing, recruiting. Start date (EU): 2019-11-15. Decision date: 2024-04-12. Results received: No. Last updated: 2026-02-11.

Condition(s): Prostate Cancer

Source: https://euclinicaltrials.eu/ctis-public/view/2024-512894-29-00